EU clinical trial 2024-515821-27-00: LAVA1207-001/LAVA1207-002 A Phase 1 and 2a open-label trial to evaluate the safety, tolerability, pharmacokinetics, pharmacodynamics, immunogenicity, and antitumor activity of LAVA-1207, a PSMA-targeting bispecific γδ-T cell engager, alone or with low dose interleukin-2 or Pembrolizumab, in patients with therapy refractory metastatic castration resistant prostate cancer
Sponsor: LAVA Therapeutics N.V. (Pharmaceutical company). Phase: Phase I and Phase II (Integrated)- Other. Countries: Spain (ended), Netherlands (ended).
Therapeutic area(s): Diseases [C] - Neoplasms [C04]
Gender: Male. Age: 18-64 years, 65+ years. Enrolment: 110.
Status: Ended. Start date (EU): 2021-11-30. End date (EU): 2025-06-18. End date: 2025-06-19. Decision date: 2024-08-27. Results received: Yes. Last updated: 2025-03-11.
Decision dates by country: ES: 2024-08-27, NL: 2024-08-27

Condition(s): Prostate Cancer, Prostate Cancer
Product: KEYTRUDA 25 mg/mL concentrate for solution for infusion

Primary endpoint: Part 1 * Frequency and severity of AEs using the Common Terminology Criteria for Adverse Events (CTCAE) version 5.0 and ASTCT grading for CRS. *Frequency and type of DLT. Part 2 * Frequency and severity of AEs using the CTCAE version 5.0 and ASTCT grading of CRS at the RP2D.
Endpoint(s): Part 1 Dose Escalation and Part 2 Expansion Cohort (for LAVA-1207 alone and/or LAVA-1207 plus LDSC IL-2 and/or LAVA-1207 plus pembrolizumab) Number of participants with an antitumor response according to immune response evaluation criteria in solid tumors (RECIST and iRECIST) in patients with measurable disease. Duration of response. Disease control rate (DCR) for patients with measurable disease at 8, 16 and 24 weeks.

Source: https://euclinicaltrials.eu/ctis-public/view/2024-515821-27-00